EU clinical trial 2022-500583-36-00: A multicenter, placebo-controlled, randomized, double-blind, parallel-group comparison trial to investigate the efficacy and safety of brexpiprazole once-weekly (QW) formulation in patients with acute schizophrenia
Protocol code: 331-102-00062
Sponsor: Otsuka Pharmaceutical Co. Ltd. (Pharmaceutical company). Phase: Therapeutic confirmatory (Phase III). Countries: Romania (ongoing, recruiting).
Therapeutic area(s): Psychiatry and Psychology [F] - Mental Disorders [F03]
Gender: Female, Male. Age: 18-64 years, 65+ years. Enrolment: 123.
Status: Ongoing, recruiting. Start date (EU): 2024-07-01. Decision date: 2023-03-03. Results received: No. Last updated: 2026-06-17.

Condition(s): Acute Schizophrenia
Product: Brexpiprazole Fumarate, Brexpiprazole Fumarate-matching Placebo, RXULTI 1 mg film-coated tablets

Primary endpoint: Primary efficacy endpoint: Mean change from baseline in the Positive and Negative Syndrome Scale (PANSS) total score at Week 6

Source: https://euclinicaltrials.eu/ctis-public/view/2022-500583-36-00